EU clinical trial 2022-502453-33-00: A Phase 2 Exploratory, Multicenter, Open-Label Trial to Determine the Safety and Preliminary Clinical Activity of GEN1046 in Combination With Anticancer Agents in Subjects With Advanced Endometrial Cancer
Protocol code: GCT1046-05
Sponsor: Genmab A/S (Pharmaceutical company). Phase: Therapeutic exploratory (Phase II). Countries: Italy (ended), Spain (ended), Belgium (ended), Denmark (ended), Poland (ended).
Therapeutic area(s): Diseases [C] - Neoplasms [C04]
Gender: Female. Age: 18-64 years, 65+ years. Enrolment: 43.
Status: Ended. Start date (EU): 2024-02-26. End date (EU): 2024-04-22. End date: 2024-04-22. Decision date: 2023-07-27. Results received: Yes. Last updated: 2024-03-26.
Decision dates by country: IT: 2023-07-31, ES: 2023-07-31, DK: 2023-07-27, PL: 2023-08-01, BE: 2023-07-31

Condition(s): Advanced Endometrial Cancer
Product: DuoBody®-PD-L1x4-1BB, KEYTRUDA 25 mg/mL concentrate for solution for infusion

Primary endpoint: Objective response rate (ORR) per Response Evaluation Criteria in Solid Tumours (RECIST) 1.1 as assessed by the investigator
Endpoint(s): Per RECIST 1.1 as assessed by the investigator: • Duration of response (DOR) • Time to response (TTR) • Disease control rate (DCR), • Incidence and severity of adverse events (AEs) • Incidence and severity of laboratory abnormalities

Source: https://euclinicaltrials.eu/ctis-public/view/2022-502453-33-00